EU clinical trial 2023-509834-20-00: A phase II, open-label, single arm study to evaluate the safety, efficacy, and pharmacokinetics of twice daily midostaurin (PKC412) combined with standard chemotherapy and as a single agent post-consolidation therapy in children with untreated FLT3-mutated AML
Protocol code: CPKC412A2218
Sponsor: Novartis Pharma AG (Pharmaceutical company). Phase: Therapeutic exploratory (Phase II). Countries: Germany (ongoing, recruitment ended), Poland (ongoing, recruitment ended), Slovenia (ongoing, recruitment ended), Czechia (ongoing, recruitment ended), Austria (ended), Italy (ongoing, recruitment ended).
Therapeutic area(s): Diseases [C] - Neoplasms [C04]
Gender: Female, Male. Age: 0-17 years. Enrolment: 13.
Start date (EU): 2019-03-13. Decision date: 2024-05-08. Results received: No. Last updated: 2025-09-18.
Decision dates by country: SI: 2024-05-09, DE: 2024-05-08, PL: 2024-05-16, AT: 2024-05-21, CZ: 2024-05-10, IT: 2024-07-22

Condition(s): untreated FLT3-mutated Acute Myeloid Leukemia
Product: IDARUBICIN, FLUDARABINE, CYTARABINE, DAUNORUBICIN, MITOXANTRONE, ETOPOSIDE, PKC412

Primary endpoint: Part 2: Safety: Frequency/severity of AEs, ECG, MUGA and laboratory Abnormalities, Part 2 : Tolerability: number of dose interruptions, dose reductions and discontinuation due to study drug
Endpoint(s): Response rate, defined as the proportion of participants with a CR or CRi according to Cheson et al (2003) and Döhner et al (2017) criteria, or modified CRi as defined in Section 4.1 at the end of Block 2., TTR criteria.Participants not experiencing CRi or better response will be censored at maximum follow-up.Participants not experiencing induction failure and who did not die will be censored at their last adequate response assessment date which is different from “unknown” or “not done”.Response duration is the time from CR, CRi or modified CRi in induction to relapse or death due to any cause.Only participants who will achieve a CRi or better response in induction will be evaluated, Event-free survival (EFS) defined as the time from Day 1 of chemotherapy until an EFS event is observed. An EFS event is defined as a failure to obtain a CR/modified CRiwithin induction, relapse after CR/modified CRi, or death due to any cause, whichever occurs first., Overall survival (OS) is defined as the time from Day 1 of chemotherapy to the date of death due to any cause. If a participant is not known to have died, survival will be censored at the date of last contact., Disease Free Survival is defined as the time from CR/modified CRi in induction to relapse or death due to any cause. This will be derived only for participants who will achieve a CR/modified CRi in induction., Percentage of participants with MRD negative status (by multiparameter flow cytometry) and duration of MRD negative status. Comparisons of percentage of participants who achieved MRD negative between the end of the consolidation phase and during the post-consolidation phase (if sufficient number of participants enter post consolidation), Assess palatability of oral solution through questionnaire assessment, Bone marrow, peripheral blood parameters and extramedullary involvement to assess morphologic remission., Plasma concentrations of midostaurin and its two major metabolites, CGP52421 and CGP62221, will be evaluated; PK parameters (AUC, Cmax if feasible, and pre-dose concentrations)

Source: https://euclinicaltrials.eu/ctis-public/view/2023-509834-20-00